EU clinical trial 2023-503385-24-00: A long-term extension study to evaluate the long-term safety, tolerability, and efficacy of subcutaneous amlitelimab in adult participants with moderate-to-severe asthma who completed treatment period of previous amlitelimab asthma clinical study
Protocol code: LTS17510
Sponsor: Sanofi-Aventis Recherche & Developpement (Pharmaceutical company). Phase: Therapeutic exploratory (Phase II). Countries: Hungary (ongoing, recruitment ended), Italy (ongoing, recruitment ended), Poland (ongoing, recruitment ended).
Therapeutic area(s): Diseases [C] - Respiratory Tract Diseases [C08]
Gender: Female, Male. Age: 18-64 years, 65+ years. Enrolment: 88.
Status: Ongoing, recruitment ended. Start date (EU): 2024-03-12. Decision date: 2023-08-29. Results received: No. Last updated: 2026-07-14.
Decision dates by country: HU: 2023-09-01, PL: 2023-09-04, IT: 2023-08-29

Condition(s): Asthma
Product: Amlitelimab, Matched placebo for test

Primary endpoint: Percentage of participants with treatment-emergent adverse events
Endpoint(s): Percentage of participants who experienced adverse events of special interest (AESI) and serious adverse events (SAEs), Annualized rate of severe exacerbation events over treatment period from parent study baseline, Annualized rate of severe exacerbation events over treatment period from LTS17510 study baseline, Time to first exacerbation event from LTS17510 study baseline, Annualized rate of severe asthma exacerbations requiring hospitalization or emergency room or urgent care visit over treatment period from parent study baseline, Annualized rate of severe asthma exacerbations requiring hospitalization or emergency room or urgent care visit over treatment period from LTS17510 study baseline, Change from parent study baseline in pre bronchodilator (BD) and post-BD forced expiratory volume in 1 second (FEV1) at each spirometry endpoint, Change from LTS17510 study baseline in pre bronchodilator (BD) and post-BD forced expiratory volume in 1 second (FEV1) at each spirometry endpoint, Change from parent study baseline in pre-BD and post-BD peak expiratory flow [PEF] at each spirometry endpoint, Change from LTS17510 study baseline in pre-BD and post-BD peak expiratory flow [PEF] at each spirometry endpoint, Change from parent study baseline in Pre-BD and post-BD forced vital capacity [FVC] at each spirometry endpoint, Change from LTS17510 study Baseline in Pre-BD and post-BD forced vital capacity [FVC] at each spirometry endpoint, Change from parent study baseline in pre-BD and post-BD forced expiratory flow [FEF] 25% to 75%) at each spirometry endpoint, Change from LTS17510 study baseline in pre-BD and post-BD forced expiratory flow [FEF] 25% to 75%) at each spirometry endpoint, Change from parent study baseline in Asthma Control Questionnaire (ACQ)-5, ACQ-6, and ACQ-7 scores, Change from LTS17510 study baseline in Asthma Control Questionnaire (ACQ)-5, ACQ-6, and ACQ-7 scores, Change from parent study baseline in Fractional Exhaled Nitric Oxide (FeNO), Change from LTS17510 study baseline in Fractional Exhaled Nitric Oxide (FeNO), Serum amlitelimab concentrations, Incidence of anti- amlitelimab antibody positive response, Change from parent study baseline and from LTS17510 in Asthma Quality of Life Questionnaire with Standardized Activities (AQLQ [S]) Self-Administered Score

Source: https://euclinicaltrials.eu/ctis-public/view/2023-503385-24-00